EU clinical trial 2023-507456-69-00: A Phase 2b, Randomized, Double-Blind, Parallel-Group, Placebo-Controlled Study to Evaluate the Efficacy and Safety of Rezpegaldesleukin in the Treatment of Adult Patients with Moderate-to-Severe Atopic Dermatitis (REZOLVE-AD).
Protocol code: 23-358-05
Sponsor: Nektar Therapeutics (Pharmaceutical company). Phase: Therapeutic exploratory (Phase II). Countries: Germany (ongoing, recruitment ended), Czechia (ongoing, recruitment ended), Poland (ongoing, recruitment ended), Spain (ongoing, recruitment ended), Croatia (ongoing, recruitment ended), Bulgaria (ongoing, recruitment ended), Hungary (ended).
Therapeutic area(s): Diseases [C] - Immune System Diseases [C20]; Diseases [C] - Skin and Connective Tissue Diseases [C17]
Gender: Female, Male. Age: 18-64 years, 65+ years. Enrolment: 366.
Start date (EU): 2024-04-25. Decision date: 2024-04-16. Results received: No. Last updated: 2026-06-12.
Decision dates by country: HR: 2024-04-19, HU: 2024-04-22, ES: 2024-04-16, BG: 2024-04-17, DE: 2024-04-17, PL: 2024-04-22, CZ: 2024-04-16

Condition(s): Atopic Dermatitis
Product: Sodium Chloride 0.9% solution, NKTR-358

Primary endpoint: Mean percent change in EASI from baseline at Week 16
Endpoint(s): Proportion of patients from baseline at Week 16 achieving • vIGA AD of 0 or 1 and at least a 2-point reduction. • EASI-75 • EASI 90 • EASI-50 • ≥ 4-point improvement from baseline in Itch NRS in the subset of patients with ≥ 4-point Itch NRS at baseline. • SCORAD-75 • SCORAD-50, Mean change from baseline over the period between Week 0 and Week 104 in • EASI • SCORAD • BSA involvement, Mean percent change from baseline over the period between Week 0 and Week 104 in • EASI • SCORAD • BSA involvement, In addition, all of the above efficacy assessments will be further evaluated at other time points during induction therapy, maintenance therapy, and follow-up - Rezpegaldesleukin plasma concentrations at various time points assessed throughout the study. - Incidence of • Serious adverse events (SAEs) • Treatment-emergent adverse events (TEAEs)

Source: https://euclinicaltrials.eu/ctis-public/view/2023-507456-69-00